EU clinical trial 2024-517535-52-00: Single center, Open-Label, Randomized Study to Evaluate the Safety and Efficacy of neoadjuvant and adjuvant Pembrolizumab on top of standard Chemo-Radiotherapy (Stupp protocol) in Treatment of Patients with newly diagnosed Glioblastoma Multiforme (GBM). (PIRG)
Protocol code: 2019/ABM/01/00062
Sponsor: Medical University Of Silesia Katowice Poland (Educational Institution). Phase: Therapeutic use (Phase IV). Countries: Poland (ongoing, recruiting).
Therapeutic area(s): Diseases [C] - Immune System Diseases [C20]
Gender: Female, Male. Age: 18-64 years, 65+ years. Enrolment: 36.
Status: Ongoing, recruiting. Start date (EU): 2022-08-24. Decision date: 2024-11-05. Results received: No. Last updated: 2025-11-21.

Condition(s): Glioblastoma Multiforme
Product: KEYTRUDA 25 mg/mL concentrate for solution for infusion

Primary endpoint: Safety and tolerability – incidence of Adverse Events (AEs) and Serious Adverse Events (SAEs) related and unrelated with Pembrolizumab, Patient-Reported Outcomes to evaluate health status and Quality of Life (QoL) instruments for patients with GBM: • Eastern Cooperative Oncology Group (ECOG) status - Karnofsky Performance Status (KPS), - EORTC: QLQ-BN20 (brain), and QLQ-C30 (general cancer questionnaire).

Source: https://euclinicaltrials.eu/ctis-public/view/2024-517535-52-00